EU clinical trial 2022-501353-37-00: A Randomized Study of Andexanet Alfa Compared to Usual Care in Patients Receiving a Factor Xa Inhibitor who Require Urgent Surgery or Procedure (ANNEXA-RS)
Protocol code: D9604C00001
Sponsor: Astrazeneca AB (Pharmaceutical company). Phase: Therapeutic confirmatory (Phase III). Countries: France (ended), Portugal (ended), Spain (ended), Bulgaria (ended), Slovakia (ended), Denmark (ended), Italy (ended), Romania (ended), Czechia (ended), Belgium (ended), Austria (ended), Greece (ended), Lithuania (ended), Germany (ended), Slovenia (ended), Estonia (ended), Poland (ended), Ireland (ended), Hungary (ended).
Therapeutic area(s): Diseases [C] - Cardiovascular Diseases [C14]
Gender: Female, Male. Age: 18-64 years, 65+ years. Enrolment: 467.
Status: Ended. End date (EU): 2024-06-13. End date: 2024-06-14. Decision date: 2024-01-10. Results received: No. Last updated: 2024-02-19.
Decision dates by country: AT: 2024-01-15, BE: 2024-01-11, BG: 2024-01-15, CZ: 2024-01-11, DK: 2024-01-10, EE: 2024-01-11, FR: 2024-01-10, GR: 2024-01-15, HU: 2024-01-15, IE: 2024-01-12, IT: 2024-01-11, LT: 2024-01-15, PT: 2024-01-12, RO: 2024-01-15, SI: 2024-01-11, ES: 2024-01-12, PL: 2024-01-12, SK: 2024-01-10, DE: 2024-01-10

Condition(s): Reversal of anticoagulation effect in patients on a FXa inhibitor (apixaban, rivaroxaban, or edoxaban) who require urgent surgery or procedure, and who have a major risk of bleeding.
Product: FIBRINOGEN, HUMAN, RIVAROXABAN, APIXABAN, ETAMSYLATE, TRANEXAMIC ACID, PROTAMINE, ERYTHROCYTES, AMINOMETHYLBENZOIC ACID, AMINOCAPROIC ACID, Ondexxya 200 mg powder for solution for infusion, EDOXABAN

Primary endpoint: Effective intraoperative hemostasis
Endpoint(s): Change in anti-FXa activity from baseline to start of surgery or procedure, Change in anti-FXa activity from baseline to 2 h post start of surgery or procedure

Source: https://euclinicaltrials.eu/ctis-public/view/2022-501353-37-00